EU clinical trial 2023-506982-73-00: A Phase II single arm open label study of Pembrolizumab and Lenvatinib in patients with high risk locally advanced cervix cancer: an EMBRACE high risk study initiative
Protocol code: Embrace-III Hi-Risk
Sponsor: Erasmus Universitair Medisch Centrum Rotterdam (Erasmus MC) (Hospital/Clinic/Other health care facility). Phase: Therapeutic exploratory (Phase II). Countries: Netherlands (authorised, recruitment pending).
Therapeutic area(s): Diseases [C] - Female Urogenital Diseases and Pregnancy Complications [C13]; Diseases [C] - Neoplasms [C04]
Gender: Female. Age: 18-64 years, 65+ years. Enrolment: 20.
Status: Authorised, recruitment pending. Decision date: 2025-11-25. Results received: No. Last updated: 2025-11-25.

Condition(s): high risk or poor response after chemoradiation and brachytherapy for locally advanced cervix cancer
Product: LENVATINIB, KEYTRUDA 25 mg/mL concentrate for solution for infusion.

Primary endpoint: Actuarial Progression free survival (PFS) rate at 24 months

Source: https://euclinicaltrials.eu/ctis-public/view/2023-506982-73-00